EU clinical trial 2023-507877-17-00: A RANDOMIZED, DOUBLE-BLIND, THREE-PART, TWO-PERIOD, TWO-SEQUENCE, SINGLE-DOSE, CROSS-OVER STUDY TO COMPARE THE PHARMACOKINETICS (PK), SAFETY AND IMMUNOGENICITY PROFILE OF MB04 (PROPOSED ETANERCEPT BIOSIMILAR), EU-SOURCED ENBREL® AND US-LICENSED ENBREL® IN HEALTHY MALE VOLUNTEERS.
Protocol code: MB04-A-01-23
Sponsor: Mabxience Research S.L. (Pharmaceutical company). Phase: Human Pharmacology (Phase I)- Bioequivalence Study. Countries: Netherlands (ended).
Therapeutic area(s): Not possible to specify
Gender: Male. Age: 18-64 years. Enrolment: 132.
Status: Ended. Start date (EU): 2024-02-12. End date (EU): 2025-06-04. Decision date: 2024-01-25. Results received: No. Last updated: 2025-01-21.
Decision dates by country: NL: 2024-05-24

Condition(s): Not applicable, Healthy Volunteers

Source: https://euclinicaltrials.eu/ctis-public/view/2023-507877-17-00